EU clinical trial 2025-524140-35-00: A Phase II Study of Naxitamab Added to Induction Therapy for Subjects with Newly Diagnosed High-Risk Neuroblastoma
Protocol code: BCC018
Sponsor: Fundacio Sant Joan De Deu (Patient organisation/association). Phase: Therapeutic exploratory (Phase II). Countries: Spain (authorised, recruiting).
Therapeutic area(s): Diseases [C] - Neoplasms [C04]
Gender: Female, Male. Age: 0-17 years, 18-64 years. Enrolment: 22.
Status: Authorised, recruiting. Start date (EU): 2026-06-29. Decision date: 2026-05-19. Results received: No. Last updated: 2026-05-19.

Condition(s): Neuroblastoma or ganglioneuroblastoma (nodular or intermixed)
Product: Humanized IgG1 monoclonal antibody against GD2

Primary endpoint: Rate of complete response (CR) at end-of-induction (EOI) per 1993 INRC as assessed by a Blinded Independent Central Review (BICR).
Endpoint(s): Rate of combined CR + VGPR at EOI per 1993 INRC as assessed by BICR Committee., Objective Response Rate (ORR; CR + VGPR + PR) at EOI per 1993 INRC by BICR Committee., Rate of CR at EOI per the 2017 INRC by BICR Committee., ORR (CR + PR) at EOI per 2017 INRC by BICR Committee., Event-free survival (EFS), defined as time from first study treatment to first event (relapse, progression, secondary malignancy, or death) or last contact., Progression-free survival (PFS), defined as time from first study treatment to documented progression or death, or censored at last contact., Overall survival (OS), defined as time from first study treatment to death, or censored at last contact., Metastatic CR rate (bone, soft tissue, and/or bone marrow) per 2017 INRC by BICR Committee at the following stages: (i) After cycle 2, (ii) After cycle 4, (iii) at EOI., Overall response category (CR, PR, MR, SD, or PD) per 2017 INRC by BICR at the following stages: (i) After cycle 2, (ii) After cycle 4, (iii) at EOI., Achievement of CR at EOI and confirmation at end of consolidation per 2017 INRC by BICR Committee., Percent change in sum of diameters of soft-tissue lesions from baseline to EOI per 2017 INRC by BICR Committee., Percent change in primary tumor volume from baseline to each induction assessment and EOI per 2017 by BICR Committee., Change in bone-marrow infiltration category from baseline to each induction assessment and EOI per 2017 INRC by BICR Committee., Change in Curie Score—overall and bone-only—from baseline to each induction assessment and EOI, and maximum change to EOI per 2017 INRC by BICR Committee., Conversion from detectable disease to MRD-negative in bone marrow at end of treatment by RT-qPCR (i.e. depth of response)., Investigator-assessed versions of all of the above., Proportion of samples for independent review needing adjudication due to discrepancy in review outcome., Incidence, severity, and relationship of adverse events (AEs) and serious adverse events (SAEs)., Incidence and duration of grade ≥3 AEs related to naxitamab., Proportion of patients with infusion-related pain by Wong-Baker and FLACC scales., AEs leading to dose delay, dose reduction, or discontinuation of naxitamab., Naxitamab related AEs preventing/delaying patients in moving on to consolidation., Naxitamab PK parameters (C_max, AUC, clearance, volume of distribution, half-life)., Incidence and titers of anti-drug antibodies.

Source: https://euclinicaltrials.eu/ctis-public/view/2025-524140-35-00